EU clinical trial 2025-523823-23-00: A study to test single and multiple doses of MER511 given to adults with Graves’ disease
Protocol code: MER511-1001
Sponsor: Merida Biosciences Inc. (Pharmaceutical company). Phase: Human Pharmacology (Phase I)- First administration to humans. Countries: Spain (authorised, recruitment pending).
Therapeutic area(s): Diseases [C] - Immune System Diseases [C20]
Gender: Female, Male. Age: 18-64 years, 65+ years. Enrolment: 28.
Status: Authorised, recruitment pending. Decision date: 2026-05-22. Results received: No. Last updated: 2026-07-28.

Condition(s): Graves’ disease

Source: https://euclinicaltrials.eu/ctis-public/view/2025-523823-23-00